EU clinical trial 2024-514285-39-00: PostoperAtIve Oxygen suppLy to reduce tempOrary deSaturation in patients after non-cardiac surgery, a prospective, randomised controlled trial (AIOLOS trial)
Sponsor: Medical University Of Graz (Educational Institution). Phase: Therapeutic confirmatory (Phase III). Countries: Austria (ongoing, recruiting).
Therapeutic area(s): Analytical, Diagnostic and Therapeutic Techniques and Equipment [E] - Therapeutics [E02]
Gender: Female, Male. Age: 65+ years. Enrolment: 210.
Status: Ongoing, recruiting. Start date (EU): 2025-03-19. Decision date: 2024-10-03. Results received: No. Last updated: 2026-01-15.

Condition(s): risk for postoperative complications after general surgery, risk for postoperative complications after urology surgery
Product: Sauerstoff medizinisch Air Liquide

Primary endpoint: SpO2-TWA<90 in the first two days after surgery, measured using pulse oximetry.
Endpoint(s): SpO2-TWA<90 in the first 24h after surgery, measured using pulse oximetry., Score of the quality of recovery using QoR-15GE questionnaire in the evening of the first postoperative day., Incidence of delirium using 3D-CAM on the first two days after surgery., Incidence of surgical site infection documented in the hospital records and follow-up call after 30 days.

Source: https://euclinicaltrials.eu/ctis-public/view/2024-514285-39-00